EU clinical trial 2023-507184-19-00: I1F-MC-RHCG: Multicenter, Open-label, Efficacy, Safety, Tolerability, and Pharmacokinetic Study of Subcutaneous Ixekizumab with Adalimumab Reference Arm, in Children with Juvenile Idiopathic Arthritis Subtypes of Enthesitis-related Arthritis (Including Juvenile-Onset Ankylosing Spondylitis) and Juvenile Psoriatic Arthritis
Protocol code: I1F-MC-RHCG
Sponsor: Eli Lilly & Co. (Pharmaceutical company). Phase: Therapeutic confirmatory (Phase III). Countries: Germany (ongoing, recruitment ended), Spain (ongoing, recruitment ended), France (ongoing, recruitment ended), Belgium (ongoing, recruitment ended), Czechia (ongoing, recruitment ended), Netherlands (ended), Italy (ongoing, recruitment ended).
Therapeutic area(s): Diseases [C] - Immune System Diseases [C20]
Gender: Female, Male. Age: 0-17 years. Enrolment: 48.
Start date (EU): 2021-02-22. Decision date: 2023-10-24. Results received: No. Last updated: 2026-06-10.
Decision dates by country: NL: 2023-11-09, BE: 2023-10-24, FR: 2023-10-24, DE: 2023-10-26, CZ: 2023-11-16, IT: 2023-11-28, ES: 2023-10-24

Condition(s): Juvenile Psoriatic Arthritis Enthesitis Related Arthritis
Product: IXEKIZUMAB, ADALIMUMAB

Primary endpoint: Percentage of Participants Achieving Juvenile Idiopathic Arthritis (JIA) American College of Rheumatology (ACR) 30 Percentage of Participants Achieving JIA ACR 30

Source: https://euclinicaltrials.eu/ctis-public/view/2023-507184-19-00